EU clinical trial 2023-509435-11-00: A Phase 1, First-in-Human, Open-Label, Dose Escalation Study of Amivantamab (JNJ61186372), a Human Bispecific EGFR and cMet Antibody, in Participants with Advanced Non-Small Cell Lung Cancer
Sponsor: Janssen Cilag International (Pharmaceutical company). Phase: Human Pharmacology (Phase I)- First administration to humans. Countries: Italy (ongoing, recruitment ended), France (ongoing, recruitment ended).
Therapeutic area(s): Diseases [C] - Neoplasms [C04]
Gender: Female, Male. Age: 18-64 years, 65+ years. Enrolment: 8.
Status: Ongoing, recruitment ended. Start date (EU): 2019-02-21. Decision date: 2024-04-29. Results received: No. Last updated: 2026-02-02.
Decision dates by country: IT: 2024-05-03, FR: 2024-04-29

Condition(s): Advanced Non-Small Cell Lung Cancer

Source: https://euclinicaltrials.eu/ctis-public/view/2023-509435-11-00